EU clinical trial 2023-503444-13-00: A Phase 3 Randomized Study Comparing Teclistamab Monotherapy versus Pomalidomide, Bortezomib, Dexamethasone (PVd) or Carfilzomib, Dexamethasone (Kd) in Participants with Relapsed or Refractory Multiple Myeloma who have Received 1 to 3 Prior Lines of Therapy, Including an Anti-CD38 Monoclonal Antibody and Lenalidomide
Protocol code: 64007957MMY3006
Sponsor: Janssen - Cilag International (Pharmaceutical company). Phase: Therapeutic confirmatory (Phase III). Countries: Italy (ongoing, recruitment ended), Denmark (ongoing, recruitment ended), Portugal (ongoing, recruitment ended), Netherlands (ongoing, recruitment ended), Poland (ongoing, recruitment ended), Sweden (ongoing, recruitment ended), Belgium (ongoing, recruitment ended), Spain (ongoing, recruitment ended), Austria (ongoing, recruitment ended), Germany (ongoing, recruitment ended), France (ongoing, recruitment ended), Czechia (ongoing, recruitment ended), Greece (ongoing, recruitment ended).
Therapeutic area(s): Diseases [C] - Hemic and Lymphatic Diseases [C15]
Gender: Female, Male. Age: 18-64 years, 65+ years. Enrolment: 291.
Status: Ongoing, recruitment ended. Start date (EU): 2023-03-29. Decision date: 2024-07-02. Results received: No. Last updated: 2026-05-13.
Decision dates by country: PT: 2024-07-02, AT: 2024-07-08, BE: 2024-07-03, DK: 2024-07-02, GR: 2024-07-22, PL: 2024-07-03, CZ: 2024-07-04, SE: 2024-07-03, ES: 2024-07-03, NL: 2024-07-04, DE: 2024-07-03, IT: 2024-07-08, FR: 2024-07-05

Condition(s): Relapsed/refractory multiple myeloma
Product: Imnovid 1 mg hard capsules, Kyprolis 60 mg powder for solution for infusion, Privigen 100 mg/ml solution for infusion, Pomalidomide, Pomalidomide, Dexamethason 8 mg GALEN® Tabletten, VELCADE 3.5 mg powder for solution for injection, Imnovid 3 mg hard capsules, Dexamethasone Tablets BP 2.0mg, Privigen 100 mg/ml solution for infusion, teclistamab, Pomalidomide, Dexamethason 4 mg JENAPHARM®, Fortecortin® 2 mg Tabletten, teclistamab, Pomalidomide, Imnovid 4 mg hard capsules, Privigen 100 mg/ml solution for infusion, Imnovid 2 mg hard capsules

Primary endpoint: progression free survival (PFS)

Source: https://euclinicaltrials.eu/ctis-public/view/2023-503444-13-00